EU clinical trial 2024-519663-17-01: Evaluation of the Pharmacokinetics of Subcutaneous Administration of Piperacillin/Tazobactam: An Open-Label, Multicentric, Non-Inferiority Randomized Clinical Trial (STUPITA01)
Sponsor: Azienda Sanitaria Universitaria Friuli Centrale (Hospital/Clinic/Other health care facility). Phase: Therapeutic exploratory (Phase II). Countries: Italy (ongoing, recruiting).
Therapeutic area(s): Diseases [C] - Bacterial Infections and Mycoses [C01]; Analytical, Diagnostic and Therapeutic Techniques and Equipment [E] - Therapeutics [E02]; Phenomena and Processes [G] - Microbiological Phenomena [G06]; Diseases [C] - Pathological Conditions, Signs and Symptoms [C23]
Gender: Female, Male. Age: 18-64 years, 65+ years. Enrolment: 240.
Status: Ongoing, recruiting. Start date (EU): 2026-06-03. Decision date: 2026-01-09. Results received: No. Last updated: 2026-05-12.

Condition(s): Infectious disease
Product: PIPERACILLIN and TAZOBACTAM for injection, single-dose vials, for intravenous use

Primary endpoint: The area under the plasma concentration-time curve (AUC) of TZP, demonstrating that TZP administration is non-inferior to IV administration. PK profile will be evaluated through the plasma antibiotic concentrations, obtained by sample collection.
Endpoint(s): -Therapeutic drug monitoring of piperacillin to ensure target concentrations non-inferior than or equal to 40 mg/L between groups, aligning with established PK/PD clinical breakpoints established; - Clinical cure rate at the end of the treatment period, defined as the partial or complete resolution of clinical signs and symptoms of infection without the need for additional antibiotic therapy; -Microbiologic success rate at EOT; - Incidence of AEs: occurrences of AEs up to 1 day after the end

Source: https://euclinicaltrials.eu/ctis-public/view/2024-519663-17-01